EU clinical trial 2022-500703-49-01: Phase 1/2a, Monocentric, Open Label Study to Evaluate the Safety, Pharmacokinetics, and Pharmacodynamics of SQY51 in Paediatric and Adult Patients with a Genetically Confirmed Diagnosis of Duchenne Muscular Dystrophy, including a i) 13-week Phase 1 Multiple Dose Escalation Phase, a ii) 49-week Phase 2a, a iii) 102-week extension phase, or a iv) 28-months long-term follow-up.
Protocol code: AVANCE1-1/2a
Sponsor: Sqy Therapeutics (Pharmaceutical company). Phase: Phase I and Phase II (Integrated)- First administration to humans. Countries: France (ongoing, recruiting).
Therapeutic area(s): Diseases [C] - Musculoskeletal Diseases [C05]
Gender: Male. Age: 0-17 years, 18-64 years. Enrolment: 12.
Status: Ongoing, recruiting. Start date (EU): 2025-11-05. Decision date: 2022-11-21. Results received: No. Last updated: 2026-02-27.

Condition(s): Duchenne muscular dystrophy

Primary endpoint: Type, frequency, severity, timing and relationship to SQY51 of: Adverse events (AEs), discontinuations due to AEs, serious AEs (SAEs)., PART III - EXTENSION PHASE : Primary and secondary objectives and endpoints of the Extension Phase are identical of the Phase 2a, with the exception that another muscle biopsy will not be performed.
Endpoint(s): Phase 2 : Motor function: - Motor Function Measure (MFM) score for ambulant and non-ambulant patients. - Performance Upper Limb (PUL) scale for ambulant and non-ambulant patients. - 6-minute walk test for ambulant patients. - 1-minute walk test (included in the 6-minute walk test) for ambulant patients. - 10-meter run/walk time for ambulant patients. - Rise from the floor for ambulant patients., Phase 2: Respiratory function: -Vital capacity, forced vital capacity, inspiratory capacity, and expiratory residual volume, functional residual capacity, residual volume, total lung capacity, all absolute values as well as percent predicted, as well as forced expiratory flow during 1 s, peak expiratory flow, peak cough flow, Tiffeneau index. -Maximal inspiratory and expiratory pressures, and sniff nasal inspiratory pressure all absolute values as well as % predicted. - Twitch mouth pressure, Phase 2 : Cardiac function : - echocardiography (LVEDD, LVESD, LVSWT, LVPWT, GLS, LVEFMS, LVMI, mitral inflow velocities, DT, E/é, LAVI, TAPSE, RV s', sPAP) - cardiac MRI (LVEDD, RVEDD, LVESD, RVESD, LVEF, RVEF, LGE, GCS, GRS, LVEDV, LVESV, systolic ejection volume, TAPSE, native T1, T2, ECV)., Phase 2 : Muscle strength: Measurements of pinch, maximal isometric grip strength using MyoGrip as well as strength of elbow flexion and extension, and knee flexion and extension using hand-held dynamometry., Phase 2 : Quality of Life Endpoints/Self-Assessment: Pediatric Quality of Life Inventory (PedsQL) – DMD module, Phase 2 : Serum biomarker analysis: Muscle necrosis biomarkers (CPK and Myomesine-3)., Phase 2 : Muscle biomarkers: - Levels of DMD exon-51 transcripts, dystrophin protein, histopathology of muscle biopsy. Lean cross-sectional areas (lCS), fat fraction (FF) and water T2 using quantitative MRI of forearm and lower leg (all patients)., Phase 1: Levels of SQY51, its main metabolites in serum and urine, and AUC calculation., Phase 2: Levels of SQY51 and main metabolites in serum, urine and muscle biopsy sample, PART III - EXTENSION PHASE : Primary and secondary objectives and endpoints of the Extension Phase are identical of the Phase 2a, with the exception that another muscle biopsy will not be performed.

Source: https://euclinicaltrials.eu/ctis-public/view/2022-500703-49-01